EU clinical trial 2024-516498-57-00: Precision Medicine in patients with unresectable CholAngiocarcinoma; RadioEmbolization and combined biological therapy (PM-CARE). Single arm, multicenter phase II study investigating the efficacy and safety of a novel therapeutic scheme in patients with unresectable CholAngiocarcinoma; RadioEmbolization in combination with CisGem and Durvalumab (MEDI4736)
Protocol code: PM-CARE
Sponsor: Ospedale San Raffaele S.r.l. (Hospital/Clinic/Other health care facility). Phase: Therapeutic exploratory (Phase II). Countries: Italy (ongoing, recruiting).
Therapeutic area(s): Diseases [C] - Digestive System Diseases [C06]; Diseases [C] - Neoplasms [C04]
Gender: Female, Male. Age: 18-64 years, 65+ years. Enrolment: 28.
Status: Ongoing, recruiting. Start date (EU): 2024-04-30. Decision date: 2024-11-18. Results received: No. Last updated: 2025-10-22.

Condition(s): liver predominant intrahepatic cholangiocarcinoma
Product: IMFINZI 50 mg/mL concentrate for solution for infusion., Cisplatino Accord Healthcare Italia 1 mg/ml concentrato per soluzione per infusione, Gemcitabina Accord 100 mg/ml concentrato per soluzione per infusione.

Primary endpoint: Efficay:Overall response rate (ORR) according to mRECIST criteria on imaging at 6 months, Safety:Evaluate adverse events, laboratory findings, vital signs and other diagnostic evaluation alterations
Endpoint(s): mRECIST criteria on imaging time points, Overall response rate according to mRECIST and RECIST 1.1 criteria at three months (interim analysis) Overall response rate according to RECIST 1.1 criteria at six months, Serial blood sampling; cytokine profiling Biopsy prior to and following treatment, Serial imaging at given time points, Tissue and blood samples, Associate ORR to mRECIST and RECIST at 6 months from the start of treatment: OS right censored to end of study

Source: https://euclinicaltrials.eu/ctis-public/view/2024-516498-57-00